EU clinical trial 2024-512689-32-00: A Phase 1b Study of the MALT1 Inhibitor JNJ-67856633 and Ibrutinib in Combination in Relapsed or Refractory B cell Non-Hodgkin Lymphoma and Chronic Lymphocytic Leukemia
Protocol code: 67856633LYM1002
Sponsor: Janssen Cilag International (Pharmaceutical company). Phase: Human Pharmacology (Phase I)- Other. Countries: France (ended), Poland (ended).
Therapeutic area(s): Diseases [C] - Neoplasms [C04]
Gender: Female, Male. Age: 18-64 years, 65+ years. Enrolment: 12.
Status: Ended. Start date (EU): 2021-07-15. End date (EU): 2025-02-13. Decision date: 2024-07-01. Results received: No. Last updated: 2024-07-01.
Decision dates by country: FR: 2024-07-01, PL: 2024-07-01

Condition(s): Non-Hodgkin lymphoma and chronic lymphocytic leukemia

Source: https://euclinicaltrials.eu/ctis-public/view/2024-512689-32-00